EU clinical trial 2025-525096-83-00: Phase II, Multicenter, Randomized Study to Evaluate Safety and Efficacy of MRD-guided Therapy with Reduced versus Standard Dose of Belantamab Mafodotin in Combination with Pomalidomide and Dexamethasone in Patients with Relapsed/Refractory Multiple Myeloma (REBEL)
Protocol code: PMC012
Sponsor: Polish Myeloma Consortium (Patient organisation/association). Phase: Therapeutic exploratory (Phase II). Countries: Poland (authorised, recruitment pending).
Therapeutic area(s): Diseases [C] - Hemic and Lymphatic Diseases [C15]
Gender: Female, Male. Age: 18-64 years, 65+ years. Enrolment: 228.
Status: Authorised, recruitment pending. Decision date: 2026-07-13. Results received: No. Last updated: 2026-07-13.

Condition(s): Relapsed/refractory Multiple myeloma
Product: Pomalidomide Viatris 4 mg hard capsules

Primary endpoint: Co-primary Endpoint 1: Overall Response Rate (ORR), defined as the proportion of patients achieving at least partial response to treatment, according to standard IMWG criteria., Co-primary Endpoint 2: Incidence of ocular toxicity of at least grade 2 severity during the study period (keratopathy and visual acuity scale [VKA] and NCI CTCAE, v.5.0)
Endpoint(s): Evaluation of safety of the treatment comprising all grades adverse events according to National Cancer Institute Common Terminology Criteria for Adverse Events, version 5.0 (NCI CTCAE, v.5.0), The percentage of participants with MRD is less than 10-5 in bone marrow in patients in CR at 6, 12, 18, 24, 30, 36, and 42 months from randomization, The percentage of patients with sustained uMRD negativity defined as two consecutive MRD negative results in patients with a complete response (CR) separated by at least 12 months, Overall response rate (ORR) percentage; defined as stringent complete response [sCR], complete response [CR], very good partial response [VGPR], partial response [PR]) as assessed by the IMWG guidelines, The percentage of participants achieving at least a complete response [CR] as assessed by the IMWG guidelines, The percentage of participants achieving at least a very good partial response [VGPR], as assessed by the IMWG guidelines, Duration of responses (DOR) (time frame: response up to disease progression or death, whichever occurs first), Progression-Free Survival (PFS) (time frame: baseline up to disease progression or death, whichever occurs first), Overall Survival (OS) (time frame: Baseline up to death), Duration of responses of participants achieving CR-MRD negative disease (DOR-MRD) (time frame: response up to disease progression or death, whichever occurs first), Subjects' quality of life (QOL) during therapy. Changes from baseline in QOL measures are assessed using the European Organization for Research and Treatment of Cancer Quality of Life Questionnaire Core 30 (EORTC QLQ-C30) and European Organisation for the Research and Treatment of Cancer Myeloma Module Quality of Life Questionnaire (EORTC QLQ-MY20).

Source: https://euclinicaltrials.eu/ctis-public/view/2025-525096-83-00